EU clinical trial 2023-507991-32-00: An open label, balanced, randomized, single dose, two treatment, two period, two sequence, crossover, bioequivalence study comparing Lacosamide tablets USP 200 mg, manufactured by Sun Laboratories Industries Limited, India with Vimpat (Lacosamide) 200 mg film-coated tablets, Marketing Authorisation Holder UCB Pharma S.A., Belgium, in healthy adult, human subjects under fasting condition.
Protocol code: LACOS-06-23
Sponsor: Sun Pharmaceutical Industries Limited (Pharmaceutical company). Phase: Human Pharmacology (Phase I)- Bioequivalence Study. Countries: Romania (ended).
Therapeutic area(s): Diseases [C] - Nervous System Diseases [C10]
Gender: Female, Male. Age: 18-64 years. Enrolment: 32.
Status: Ended. Start date (EU): 2024-07-25. End date (EU): 2024-09-03. Decision date: 2024-02-19. Results received: No. Last updated: 2024-02-19.

Condition(s): Epileptic seizures

Source: https://euclinicaltrials.eu/ctis-public/view/2023-507991-32-00